EU clinical trial 2024-519012-14-00: Effect of impact of PCSK9 inhibitor on coronary microvascular dysfunction in patients with atherosclerotic cardiovascular disease needing coronarography.
Protocol code: 38RC19.186
Sponsor: Centre Hospitalier Universitaire Grenoble Alpes (Hospital/Clinic/Other health care facility). Phase: Therapeutic exploratory (Phase II). Countries: France (ongoing, recruitment ended).
Therapeutic area(s): Diseases [C] - Cardiovascular Diseases [C14]
Gender: Female, Male. Age: 18-64 years, 65+ years. Enrolment: 66.
Status: Ongoing, recruitment ended. Start date (EU): 2020-09-15. Decision date: 2024-11-15. Results received: No. Last updated: 2024-11-15.

Condition(s): atherosclerotic cardiovascular disease
Product: Repatha 140 mg solution for injection in pre-filled pen

Primary endpoint: Index of microcirculatory resistance (IMR), measured during invasive coronary angiography (ICA) (in mmHg.s).
Endpoint(s): Troponin I level after PCI., Coronary angiography parameters and coronary physiology: % epicardial stenosis, FFR, CFR, IMR, Resting ultrasound parameters: systolic and diastolic function, myocardial deformation.

Source: https://euclinicaltrials.eu/ctis-public/view/2024-519012-14-00